EU clinical trial 2022-501563-40-00: Phase 1 Study of MK-1084 in KRAS mutant advanced solid tumors
Protocol code: MK-1084-001
Sponsor: Merck Sharp & Dohme LLC (Pharmaceutical company). Phase: Human Pharmacology (Phase I)- First administration to humans. Countries: Spain (ongoing, recruiting), Poland (ongoing, recruiting), Italy (ongoing, recruiting), France (not authorised), Denmark (ongoing, recruiting), Lithuania (ongoing, recruiting).
Therapeutic area(s): Diseases [C] - Neoplasms [C04]
Gender: Female, Male. Age: 18-64 years, 65+ years. Enrolment: 167.
Start date (EU): 2021-12-16. Decision date: 2023-09-07. Results received: No. Last updated: 2026-05-08.
Decision dates by country: LT: 2025-01-17, ES: 2023-09-07, PL: 2023-09-25, DK: 2024-06-18, IT: 2024-04-02

Condition(s): Solid tumor cancer and lung cancer

Source: https://euclinicaltrials.eu/ctis-public/view/2022-501563-40-00